EU clinical trial 2026-525419-16-00: Randomized, observer-blind, placebo-controlled, four Parallel Group, Clinical Trial for exploring the Efficacy and Tolerability of two different strengths ketotifen nasal spray (Ketotifen 0.025 mcg/ml and 0.050 mcg/ml) vs sodium cromoglicate nasal spray 2% in Patients with Rhinitis
Protocol code: BECRO/PS/NASUS
Sponsor: Eudemus Pharmaceuticals Limited (Pharmaceutical company). Phase: Therapeutic exploratory (Phase II). Countries: Greece (authorised, recruitment pending).
Therapeutic area(s): Diseases [C] - Otorhinolaryngologic Diseases [C09]
Gender: Female, Male. Age: 0-17 years, 18-64 years, 65+ years. Enrolment: 120.
Status: Authorised, recruitment pending. Decision date: 2026-07-16. Results received: No. Last updated: 2026-07-16.

Condition(s): Rhinitis
Product: Placebo Nasal Spray, Ketotifen 0.050% (0.50 mg/mL), Cromo-ratiopharm® Nasenspray, Ketotifen 0.025% (0.25mg/mL)

Primary endpoint: Change in VAS score in the patient symptom sumscore [from final visit (week 12) to baseline]
Endpoint(s): Change in VAS score in the patient symptom sumscore [from follow-up visit (week 4) to baseline], Change in iTNSS from final visit (week 12) to baseline, Change in iTNSS from follow-up visit (week 4) to baseline, Change in ARS score from final visit (week 12) to baseline, Change in ARS score from follow-up visit (week 4) to baseline

Source: https://euclinicaltrials.eu/ctis-public/view/2026-525419-16-00